EU clinical trial 2024-517288-22-01: HEMATOVAC-Immunogenicity of an Anti-pneumococcal Combined Vaccination (PCV13+PPV23 versus PREVENAR20) in Lymphoma
Protocol code: HEMATOVAC
Sponsor: Centre Hospitalier Universitaire De Poitiers (Hospital/Clinic/Other health care facility). Phase: Therapeutic use (Phase IV). Countries: France (temporarily halted).
Therapeutic area(s): Phenomena and Processes [G] - Immune system processes [G12]
Gender: Female, Male. Age: 18-64 years, 65+ years. Enrolment: 160.
Status: Temporarily halted. Start date (EU): 2021-01-29. Decision date: 2024-10-17. Results received: No. Last updated: 2026-05-22.

Condition(s): Lymphoma
Product: Prevenar 13 suspension for injection in single dose vial pneumococcal polysaccharide conjugate vaccine (13-valent, adsorbed), Prevenar 20 suspension for injection in pre-filled syringe Pneumococcal polysaccharide conjugate vaccine (20-valent, adsorbed), PNEUMOVAX, solution injectable en seringue préremplie. Vaccin pneumococcique polyosidique

Primary endpoint: Proportion of patients responding to the combined vaccination strategy (PCV13 + PPV23) assessed 4 weeks after PPV23 vaccination compared with the PREVENAR20 single injection vaccination strategy assessed 3 months post-injection according to the level of anti-pneumococcal IgG
Endpoint(s): Proportion of patients having an ELISA serotype-specific IgG titer ≥ 1.3μg/mL (WHO threshold) and a two-fold increase of this IgG titer compared to baseline at 4 weeks after the PCV13 injection or PREVENAR20, Proportion of patients having a sustainable response to vaccination defined by an ELISA serotype-specific IgG titer ≥ 1.3μg/mL and a two-fold increase of this IgG titer compared to baseline between 3-6 months after the PPV23 injection or 5-8 months after PREVENAR20 injection, Proportion of patients having a sustainable response to vaccination defined by the same criteria as the primary outcome and measured between 9-12 months after the PPV23 injection or 11-14 months after PREVENAR20 injection, Proportion of responding patients having titers of IgG, IgG2, IgM, and IgA rising significantly at 4 weeks after PCV13 injection, and 4 weeks, 3- 6 months and 9-12 months after PPV23 injectionor at 4 weeks, 3 months, 5-8 months, 11-14 months after PREVENAR20 injection., To determine predictive factors for non-response to vaccination at 4weeks, and 6-12 months after PPV23 injection/11-14 months PREVENAR 20 such as age, hematological malignancy, immune status, chemotherapy,....., Number of patients having local or general reactions to vaccination and number of invasive pneumococcal infections with a documented serotype considered as vaccination failure, To assess the concordance between the reference immuno-monitoring dosage (WHO ELISA) and another kit of dosage (Vacczyme® Binding Site®).

Source: https://euclinicaltrials.eu/ctis-public/view/2024-517288-22-01